EU clinical trial 2024-518692-56-00: The optimal timing of vaccination in pregnancy: a multi-dimensional mechanistic approach to measure immune responses in pregnant women (MATIMMUNE)
Sponsor: University Of Antwerp (Educational Institution). Phase: Therapeutic use (Phase IV). Countries: Belgium (authorised, recruitment pending).
Therapeutic area(s): Phenomena and Processes [G] - Immune system processes [G12]; Diseases [C] - Respiratory Tract Diseases [C08]
Gender: Female. Age: 18-64 years. Enrolment: 96.
Status: Authorised, recruitment pending. Decision date: 2024-10-24. Results received: No. Last updated: 2024-10-24.

Condition(s): Pregnant
Product: Triaxis, suspensie voor injectie in een voorgevulde spuit. Difterie, tetanus, kinkhoest (acellulaire component) vaccin (geadsorbeerd, gereduceerde antigen(en)inhoud)

Primary endpoint: Measurement of antibody levels and functional antibody characteristics in maternal blood with Tdap vaccination at different timings in pregnancy (measurement at baseline, after Tdap vaccination, at delivery and 6 months postpartum).
Endpoint(s): Measurement of cytokine levels and T-cell subsets in maternal blood after Tdap vaccination at different timings in pregnancy (measurement at baseline, after Tdap vaccination, at delivery and 6 months postpartum)., Measurement of antibody levels in cord blood at delivery after Tdap vaccination at different timings in pregnancy to calculate the transport of antibodies across the placenta., Measurement of antibody levels, subclass antibody levels, antibody glycosylation and antibody functionality in breastmilk 6 months postpartum after Tdap vaccination at different timings in pregnancy.

Source: https://euclinicaltrials.eu/ctis-public/view/2024-518692-56-00